EU clinical trial 2022-501250-12-01: Clinical study to evaluate the safety and tolerability of SPVN06 (novel gene therapy) in a subset of patients with rod cone dystrophy (RCD).
Protocol code: SPVN06-CLIN-01
Sponsor: Sparingvision (Pharmaceutical company). Phase: Phase I and Phase II (Integrated)- First administration to humans. Countries: France (ongoing, recruitment ended).
Therapeutic area(s): Diseases [C] - Eye Diseases [C11]
Gender: Female, Male. Age: 18-64 years, 65+ years. Enrolment: 17.
Status: Ongoing, recruitment ended. Start date (EU): 2023-03-17. Decision date: 2023-03-03. Results received: No. Last updated: 2026-02-11.

Condition(s): Inherited retinal dystrophies

Source: https://euclinicaltrials.eu/ctis-public/view/2022-501250-12-01